EU clinical trial 2023-505159-35-00: SEDICAN: Sex differences in the acute effects of cannabis
Protocol code: 2023-505159-35-00
Sponsor: Bedrocan International B.V. (Pharmaceutical company). Phase: Human Pharmacology (Phase I)- Other. Countries: Netherlands (authorised, recruitment pending).
Therapeutic area(s): Psychiatry and Psychology [F] - Psychological Phenomena [F02]
Gender: Female, Male. Age: 18-64 years. Enrolment: 54.
Status: Authorised, recruitment pending. Decision date: 2024-02-06. Results received: No. Last updated: 2024-10-04.

Condition(s): N/A - healthy volunteers

Source: https://euclinicaltrials.eu/ctis-public/view/2023-505159-35-00